EU clinical trial 2024-515409-25-00: Persistence of major molecular remission in chronic myeloid leukemia after a second stop of TKI treatment in patients who failed an initial stop attempt: a multicenter prospective trial. DASTOP2 TRIAL
Protocol code: 2016-004106-34
Sponsor: Region Uppsala (Hospital/Clinic/Other health care facility). Phase: Therapeutic exploratory (Phase II). Countries: France (ongoing, recruiting), Netherlands (ongoing, recruiting), Denmark (ongoing, recruiting).
Therapeutic area(s): Diseases [C] - Hemic and Lymphatic Diseases [C15]; Diseases [C] - Neoplasms [C04]
Gender: Female, Male. Age: 18-64 years, 65+ years. Enrolment: 32.
Status: Ongoing, recruiting. Start date (EU): 2018-01-11. Decision date: 2024-09-17. Results received: No. Last updated: 2025-03-03.
Decision dates by country: NL: 2024-09-17, DK: 2025-01-27, FR: 2024-09-23

Condition(s): Chronic myeloid leukemia
Product: SPRYCEL 20 mg film-coated tablets, SPRYCEL 50 mg film-coated tablets

Primary endpoint: The proportion of patients maintaining MMR at 6 and 12 months after discontinuing TKI a second time (survival without loss of major molecular response, MMR, defined as BCR-ABL1>0.1% on IS at one time point).
Endpoint(s): Number of patients who re-achieved stable MR4, and were offered study participation; and overall and progression-free survival and the occurrence of a restart of TKI without prior molecular relapse., Clinical and biological factors correlating with persistence of MMR or better after second TKI stop (BCR-ABL level before 2nd stop, Sokal score, gender, duration and type of TKI-treatment, duration of first TKI-stop, immunological biomarkers)., Time to reachievement of MR4 after second loss of MMR., Adverse events related to second TKI stop, clinical and biological factors correlated to development of these AEs.

Source: https://euclinicaltrials.eu/ctis-public/view/2024-515409-25-00